EU clinical trial 2025-521710-25-00: A Double-Blind, Placebo-Controlled, Phase 2, Efficacy and Safety Study of ACP-204 in Adults with Lewy Body Dementia Psychosis (LBDP)
Protocol code: ACP-204
Sponsor: Acadia Pharmaceuticals Inc. (Pharmaceutical company). Phase: Therapeutic exploratory (Phase II). Countries: Bulgaria (ongoing, recruiting), Czechia (ongoing, recruiting), Italy (ongoing, recruiting), France (ongoing, recruiting).
Therapeutic area(s): Diseases [C] - Nervous System Diseases [C10]
Gender: Female, Male. Age: 18-64 years, 65+ years. Enrolment: 77.
Status: Ongoing, recruiting. Start date (EU): 2025-12-04. Decision date: 2025-10-29. Results received: No. Last updated: 2026-05-05.
Decision dates by country: FR: 2025-11-03, IT: 2025-10-30, BG: 2025-11-03, CZ: 2025-10-29

Condition(s): Lewy Body Dementia Psychosis (LBDP)
Product: Placebo for ACP-204 capsules

Primary endpoint: Change from Baseline in SAPS-LBDP total score at Week 6

Source: https://euclinicaltrials.eu/ctis-public/view/2025-521710-25-00